EU clinical trial 2023-503465-33-00: Long-term Safety and Tolerability Study of Linerixibat for the Treatment of Cholestatic Pruritus in Participants with Primary Biliary Cholangitis
Protocol code: 212358
Sponsor: Glaxosmithkline Research & Development Limited (Pharmaceutical company). Phase: Therapeutic confirmatory (Phase III). Countries: Czechia (ongoing, recruitment ended), Belgium (ended), Spain (ongoing, recruitment ended), Italy (ongoing, recruitment ended), Greece (ended), Germany (ongoing, recruitment ended), France (ended), Bulgaria (ongoing, recruitment ended), Poland (ongoing, recruitment ended).
Therapeutic area(s): Diseases [C] - Digestive System Diseases [C06]
Gender: Female, Male. Age: 18-64 years, 65+ years. Enrolment: 82.
Start date (EU): 2020-07-03. Decision date: 2023-08-24. Results received: No. Last updated: 2026-07-20.
Decision dates by country: GR: 2023-10-02, BE: 2023-08-25, FR: 2023-09-25, BG: 2023-10-09, ES: 2023-08-28, PL: 2023-11-10, CZ: 2023-08-24, DE: 2023-09-28, IT: 2023-08-24

Condition(s): Cholestasis

Primary endpoint: "Frequency and severity of adverse events - From start of treatment (Day1) to end of study or until the follow up phone call after early study withdrawal (Day 7 to 14 post-final dose of IP). Assessments are made on Day 1, Week 1, Months 1, 2, 3, 6, 9, 12, 18, 24, 30, 36, 42, 48 (Additional visits as needed) and final follow phone call on Day 7 to Day 14 post final dose of IP. "
Endpoint(s): "1. Change in domain scores of the PBC-40 and BDI-II over time 2. Change in clinically meaningful lab values incl. liver parameters and lipids over time Group 1 only 2. Change in health-related QoL and EQ VAS (EQ-5D-3L) over time. Group 2 only (Responder=R = ≥2, ≥3 and ≥4 points reduction in MIS) 1. R at w24, at w52 of continuous treatment 2. Maintenance of efficacy at w52 for those who were R at w24 3. Change from Baseline in Monthly Sleep and Fatigue Scores over 52 w of cont. treatment"

Source: https://euclinicaltrials.eu/ctis-public/view/2023-503465-33-00